EU clinical trial 2024-513905-29-00: Long-Term Follow-up of Subjects With Transfusion-Dependant β-Thalassemia Treated With Ex Vivo Gene Therapy Using Autologous Hematopoietic Stem Cells Transduced With a Lentiviral Vector
Protocol code: LTF-303
Sponsor: Genetix Biotherapeutics Inc. (Pharmaceutical company). Phase: Therapeutic confirmatory (Phase III). Countries: Germany (ongoing, recruitment ended), France (ongoing, recruitment ended), Italy (ongoing, recruitment ended), Greece (ongoing, recruitment ended).
Therapeutic area(s): Diseases [C] - Hemic and Lymphatic Diseases [C15]
Gender: Female, Male. Age: 0-17 years, 18-64 years. Enrolment: 24.
Status: Ongoing, recruitment ended. Start date (EU): 2008-10-16. Decision date: 2024-09-12. Results received: No. Last updated: 2025-12-18.
Decision dates by country: FR: 2024-09-12, DE: 2024-09-17, GR: 2024-11-13, IT: 2024-10-14

Condition(s): Beta-thalassaemia
Product: LentiGlobin BB305 Drug Product

Primary endpoint: The number of subjects with malignancies, The number of subjects with immune-related AEs (e.g., autoimmune disorders, GVHD, opportunistic infections, HIV), The number of subjects with new or worsening hematologic disorders, The number of subjects with new or worsening neurologic disorders
Endpoint(s): βA-T87Q-globin expression in peripheral blood over time post-drug product infusion through last follow-up, including Year 5, Year 10, and Year 15, Proportion of subjects who meet the definition of transfusion independence (TI), defined as a weighted average Hb ≥ 9 g/dL without any pRBC transfusions for a continuous period of ≥ 12 months at any time after drug product infusion in parent study and/or Study LTF-303, Proportion of subjects who meet the definition of TI at yearly timepoints including Year 5, Year 10, and Year 15 post-drug product infusion, and at last follow-up, Characterization of TI: Time from drug product infusion to achievement of TI (in parent study or Study LTF-303); Duration of TI; Weighted average Hb during T, Characterization of transfusion reduction (TR): Reduction in annualized pRBC transfusion volume (mL/kg/year) from 6 months post-drug product infusion (parent study) through last followup of at least 50%, 60%, 75%, 90%, or 100% as compared to the annualized pRBC transfusion volume during the 2 years prior to parent study enrollment, Characterization of transfusion reduction (TR):Annualized pRBC transfusion volume (mL/kg/year) and frequency (number/year) from 6 months post-drug product infusion (parent study) through last follow-up as compared to the annualized pRBC transfusion requirements during the 2 years prior to parent study enrollment, Characterization of transfusion reduction (TR): Time from drug product infusion to last pRBC transfusion (in parent study or Study LTF-303), Characterization of transfusion reduction (TR): Time from last pRBC transfusion (in parent study or Study LTF-303) to last follow-up, Weighted average nadir Hb from 6 months post-drug product infusion (parent study) through last follow-up as compared to the weighted average nadir Hb during the 2 years prior to parent study enrollment, Unsupported total Hb levels over time through last follow-up, including Year 5, Year 10, and Year 15, Unsupported total Hb levels ≥ 10 g/dL, ≥ 11 g/dL, ≥ 12 g/dL, ≥ 13 g/dL, and ≥ 14 g/dL over time through last follow-up, including Year 5, Year 10, and Year 15, Iron burden over time and change from parent study baseline in iron burden at yearly timepoints through last follow-up, as measured by: Liver iron content by magnetic resonance imaging (MRI)/Superconducting Quantum Interference Device (SQUID) as available ; Cardiac T2* by MRI as available ; Serum ferritin, Chelation therapy use, including time from last use of chelation therapy to last follow-up and absence of chelation use for at least 6 months post-drug product infusion in parent study and/or Study LTF-303, Therapeutic phlebotomy use, including annualized frequency, Measures of dyserythropoiesis over time as compared to parent study baseline, assessed by the following parameters: Reticulocytes ; Nucleated RBCs, Health-related quality of life (HRQoL) over time as compared to parent study baseline, using the following validated tools as available and as appropriate: Pediatric Quality of Life Inventory (PedsQL) ; EuroQol-5D (EQ-5D; youth version, EQ-5D-Y) ; Short Form-36 (SF-36) v2 ; Functional Assessment of Cancer Therapy-Bone Marrow Transplant (FACT-BMT)

Source: https://euclinicaltrials.eu/ctis-public/view/2024-513905-29-00